EU clinical trial 2025-524719-35-00: A Phase 1b/2a, Multicenter, Double-Blind, Placebo-Controlled Study to Evaluate the Safety, Efficacy, and Pharmacokinetics of MB-001 in Participants With Moderately to Severely Active Ulcerative Colitis
Protocol code: MB-001-102
Sponsor: Mage Biologics Inc. (Pharmaceutical company). Phase: Phase I and Phase II (Integrated)- Other. Countries: Poland (ongoing, recruiting).
Therapeutic area(s): Diseases [C] - Digestive System Diseases [C06]
Gender: Female, Male. Age: 18-64 years, 65+ years. Enrolment: 30.
Status: Ongoing, recruiting. Start date (EU): 2026-05-22. Decision date: 2026-04-29. Results received: No. Last updated: 2026-05-06.

Condition(s): Ulcerative Colitis
Product: MB-001, The placebo has the same formulation excipients as the MB-001 drug product except that it contains no active ingredient.

Primary endpoint: Incidence of adverse events (AEs), treatment emergent AEs (TEAEs), serious AEs, AEs of special interest, and treatment discontinuation due to TEAEs through Week 12, Changes in clinical laboratory parameters, physical examination findings, and vital signs through Week 12, Proportion of participants achieving clinical remission, defined by a modified Mayo Score (mMS) ≤ 2 with a Mayo endoscopic subscore (MES) ≤ 1, rectal bleeding (RB) subscore of 0, and stool frequency (SF) subscore ≤ 1, at Week 12
Endpoint(s): Proportion of participants achieving endoscopic improvement, defined as an MES ≤ 1, at Week 12, Proportion of participants achieving endoscopic remission, defined as an MES = 0, at Week 12, Proportion of participants achieving mMS clinical response, defined as a reduction from Baseline ≥ 2 points and ≥ 30% in mMS, with a reduction ≥ 1 in RB subscore or absolute RB subscore ≤ 1, at Week 12, Proportion of participants achieving symptomatic remission, defined as a SF subscore of 0 and an RB subscore of 0, at Week 12, Proportion of participants achieving histologic remission, defined as a Geboes Score ≤ 2B.0, at Week 12, Proportion of participants achieving histologic remission, defined as Robarts Histopathology Index ≤ 3 with subscores of 0 for lamina propria neutrophils, neutrophils in the epithelium, and erosions/ulcers, at Week 12, Proportion of participants achieving histologic endoscopic mucosal improvement, defined as a Geboes Score ≤ 3.1 and MES ≤ 1, at Week 12, Proportion of participants achieving mucosal healing, defined as a Geboes Score ≤ 2B.1 and MES ≤ 1, at Week 12

Source: https://euclinicaltrials.eu/ctis-public/view/2025-524719-35-00